EU clinical trial 2024-517719-65-00: Neoadjuvant FOLFIRINOX versus upfront surgery for resectable pancreatic head cancer : a multicentre, randomised, phase 2 trial (Nordic Pancreatic Cancer Trial (NORPACT) – 1
Protocol code: NORPACT-1
Sponsor: Oslo University Hospital HF (Hospital/Clinic/Other health care facility). Phase: Therapeutic exploratory (Phase II). Countries: Sweden (ongoing, recruiting), Norway (ongoing, recruiting).
Therapeutic area(s): Diseases [C] - Neoplasms [C04]
Gender: Female, Male. Age: 18-64 years, 65+ years. Enrolment: 131.
Status: Ongoing, recruiting. Start date (EU): 2017-02-01. Decision date: 2024-11-11. Results received: No. Last updated: 2024-11-12.
Decision dates by country: SE: 2024-11-11, NO: 2024-11-12

Condition(s): Resectable pancreatic head cancer
Product: FLUOROURACIL, GEMCITABINE, IRINOTECAN, CAPECITABINE, OXALIPLATIN, CALCIUM FOLINATE

Primary endpoint: Overall survival at 18 months after the date of randomisation
Endpoint(s): Progression-free survival assessed at both 18 months and as time since randomisation,, Overall mortality at 1 year after commencement of allocated treatment for patients who ultimately underwent resection, Overall survival in both the intention-to-treat (ITT) and per-protocol populations, Overall survival and overall survival following resection, Histopathological response (R0 resection and [y]pN0 disease), Compliication rates at 90 days after surgery, Feasibility of neoadjuvant and adjuvant chemotherapy (as assessed by adverse events, dose reductions, and dose delays),, Completion rates of all parts of multimodal treatment, Health economics, Quality of life

Source: https://euclinicaltrials.eu/ctis-public/view/2024-517719-65-00